EU clinical trial 2024-519565-21-01: Effects of combined diuretic therapy on exercise capacity, alveolar-capillary diffusion and maintenance of euvolemia in chronic congestive heart failure, diuretic therapy compared with loop diuretics and potassium-sparing diuretics
Protocol code: CCM 1862
Sponsor: Centro Cardiologico Monzino S.p.A. (Hospital/Clinic/Other health care facility). Phase: Therapeutic confirmatory (Phase III). Countries: Italy (ongoing, recruiting).
Therapeutic area(s): Diseases [C] - Cardiovascular Diseases [C14]
Gender: Female, Male. Age: 18-64 years, 65+ years. Enrolment: 44.
Status: Ongoing, recruiting. Start date (EU): 2023-09-21. Decision date: 2025-03-11. Results received: No. Last updated: 2025-12-18.

Condition(s): congestive heart failure
Product: Zaroxolyn 5 mg compresse, Zaroxolyn 10 mg compresse, DIAMOX 250 mg compresse

Primary endpoint: Evaluate differences in the trend of short- to medium-term re-hospitalizations between chronic heart failure patients treated with standard diuretic therapy (control arm) and combination diuretic therapy (experimental arm)

Source: https://euclinicaltrials.eu/ctis-public/view/2024-519565-21-01